EU clinical trial 2024-518454-17-00: PHASE I STUDY TO DETERMINE THE MAXIMUM TOLERATED DOSE FOR TRICHOSTATIN A IN SUBJECTS WITH RELAPSED OR REFRACTORY HEMATOLOGIC MALIGNANCIES
Protocol code: VP-VTR-297-1101
Sponsor: Vanda Pharmaceuticals Inc. (Pharmaceutical company). Phase: Human Pharmacology (Phase I)- First administration to humans. Countries: Poland (ongoing, recruiting).
Therapeutic area(s): Diseases [C] - Neoplasms [C04]
Gender: Female, Male. Age: 18-64 years, 65+ years. Enrolment: 30.
Status: Ongoing, recruiting. Start date (EU): 2021-01-08. Decision date: 2024-12-23. Results received: No. Last updated: 2026-05-25.

Condition(s): relapsed/refractory hematologic malignancies

Source: https://euclinicaltrials.eu/ctis-public/view/2024-518454-17-00